EU clinical trial 2024-514244-81-00: CANDISHORT : A randomized study of a short duration therapy for candidemia
Protocol code: APHP230824
Sponsor: Assistance Publique Hopitaux De Paris (Hospital/Clinic/Other health care facility). Phase: Therapeutic confirmatory (Phase III). Countries: France (authorised, recruitment pending).
Therapeutic area(s): Diseases [C] - Bacterial Infections and Mycoses [C01]; Analytical, Diagnostic and Therapeutic Techniques and Equipment [E] - Therapeutics [E02]
Gender: Female, Male. Age: 18-64 years, 65+ years. Enrolment: 399.
Status: Authorised, recruitment pending. Decision date: 2026-03-06. Results received: No. Last updated: 2026-06-26.

Condition(s): Uncomplicated candidemia
Product: ANIDULAFUNGIN, MICAFUNGIN, MICAFUNGIN, AMPHOTERICINE B, LIPOSOME, CASPOFUNGIN, CASPOFUNGIN, VORICONAZOLE, AMPHOTERICINE B, LIPOSOME, FLUCONAZOLE, VORICONAZOLE, ANIDULAFUNGIN, FLUCONAZOLE

Primary endpoint: The Primary endpoint will be ACM at Day 28 (+/- 2 days) after the 1st negative blood for all randomized patients under antifungal treatment with a diagnosis of uncomplicated candidemia.
Endpoint(s): Proportion of randomized patients with secondary localizations at Day 28 (+/- 2 days), Cumulative incidence of death related to fungal infection at Day 28 (+/- 2 days) after the 1st negative blood culture, Liver function tests (ASAT, ALAT, GGT, PAL, bilirubin blood levels) according to the two treatment strategies at inclusion (Visit 1) randomization (Visit 2), at D14 (+/- 2 days) (Visit 3) (D1: day of the 1st drawn negative blood culture), Incremental cost effectiveness ratio: cost per extra-day alive without antifungal treatment up to D28 (+/- 2 days) (Visit 4) if patients still hospitalized, Proportion of randomized patients with relapse at D45 (+/- 2 days), Proportion of randomized patients with secondary localization at D45 (+/- 2 days), Incremental cost effectiveness ratio : cost per extra-day alive without antifungal treatment up to D45 (+/- 2 days) (Visit 5) if patients still hospitalized.

Source: https://euclinicaltrials.eu/ctis-public/view/2024-514244-81-00